EU clinical trial 2023-507069-25-00: A Phase 2, Multicohort Study of Daratumumab-Based Therapies in Participants with Amyloid Light Chain (AL) Amyloidosis
Protocol code: 54767414AMY2009
Sponsor: Janssen - Cilag International (Pharmaceutical company). Phase: Therapeutic exploratory (Phase II). Countries: Germany (ended), France (ended), Spain (ended), Netherlands (ended), Italy (ended), Greece (ended).
Therapeutic area(s): Diseases [C] - Immune System Diseases [C20]
Gender: Female, Male. Age: 18-64 years, 65+ years. Enrolment: 118.
Status: Ended. Start date (EU): 2022-04-29. End date (EU): 2026-06-09. Decision date: 2023-11-29. Results received: No. Last updated: 2026-04-29.
Decision dates by country: DE: 2023-11-30, NL: 2023-11-30, ES: 2023-11-29, FR: 2023-11-30, IT: 2024-01-12, GR: 2024-01-24

Condition(s): Amyloid Light Chain Amyloidosis
Product: DEXAMETHASONE SODIUM PHOSPHATE, VELCADE 3.5 mg powder for solution for injection, DARATUMUMAB, CYCLOPHOSPHAMIDE

Primary endpoint: incidence of any toxicity grade of cardiac events, - C[trough]
Endpoint(s): Overall HemCR and HemCR rate at 6 months, Rate of VGPR or better, Time to HemCR (or VGPR or better), Duration of response (HemCR and VGPR or better), Organ response rate (OrRR) at 6 months and 12 months for kidney, heart, liver, Overall survival (OS), Time to next treatment (TNT), Incidence and severity of AEs, Pharmacokinetic profile of daratumumab, Immunogenicity of daratumumab and rHuPH20, Clinical signs and symptoms of cardiac AL amyloidosis

Source: https://euclinicaltrials.eu/ctis-public/view/2023-507069-25-00